EU clinical trial 2024-511188-26-00: A Phase 3, Randomized, Open-Label Study to Compare the Efficacy and Safety of Anitocabtagene Autoleucel Versus Standard of Care Therapy in Participants With Relapsed/Refractory Multiple Myeloma
Protocol code: KT-US-679-0788
Sponsor: Kite Pharma Inc. (Pharmaceutical company). Phase: Therapeutic confirmatory (Phase III). Countries: France (ongoing, recruitment ended), Belgium (ongoing, recruitment ended), Poland (ongoing, recruitment ended), Netherlands (ongoing, recruitment ended), Czechia (ongoing, recruitment ended), Germany (ongoing, recruitment ended), Spain (ongoing, recruitment ended), Italy (ongoing, recruitment ended), Austria (ongoing, recruitment ended).
Therapeutic area(s): Diseases [C] - Neoplasms [C04]
Gender: Female, Male. Age: 18-64 years, 65+ years. Enrolment: 192.
Status: Ongoing, recruitment ended. Start date (EU): 2024-12-20. Decision date: 2024-12-09. Results received: No. Last updated: 2026-02-23.
Decision dates by country: DE: 2025-01-02, IT: 2024-12-12, AT: 2024-12-15, CZ: 2024-12-11, BE: 2024-12-10, ES: 2024-12-12, NL: 2024-12-12, PL: 2024-12-16, FR: 2024-12-09

Condition(s): Relapsed/refractory multiple myeloma in patients who have received 1 to 3 prior lines of therapy and have been exposed to both an immunomodulatory drug and an anti-CD38 monoclonal antibody
Product: Imnovid 3 mg hard capsules, DARZALEX 20 mg/mL concentrate for solution for infusion, Bortezomib Fresenius Kabi 3.5 mg powder for solution for injection, DARZALEX 20 mg/mL concentrate for solution for infusion, Kyprolis 30 mg powder for solution for infusion, Kyprolis 60 mg powder for solution for infusion, Imnovid 1 mg hard capsules, Neofordex 40 mg tablets, Imnovid 4 mg hard capsules, Imnovid 2 mg hard capsules, Kyprolis 10 mg powder for solution for infusion, Anitocabtagene autoleucel, Bortezomib Fresenius Kabi 1 mg powder for solution for injection, DARZALEX 20 mg/mL concentrate for solution for infusion, Bortezomib Fresenius Kabi 2.5 mg powder for solution for injection

Primary endpoint: PFS, defined as the time to disease progression per IMWG criteria as determined by IRC, or death due to any cause, whichever occurs first, Minimal residual disease (MRD)-negative complete response (CR) rate at 9 months, defined as the proportion of participants achieving CR/stringent CR (sCR) and MRD-negative status at 9 months. MRD negativity at 9 months is defined as negative MRD value at 9 months (± 3 months) in bone marrow assessment (< 1 in 105 nucleated cells per IMWG criteria using NGS) {Kumar 2016}. CR/sCR per IMWG criteria is determined by IRC
Endpoint(s): Complete response (CR) rate (CR/stringent CR [sCR]) per IMWG criteria by IRC, Overall minimal residual disease (MRD) negativity (minimum 10^−5), Overall survival (OS), Overall response rate, MRD-negative CR/sCR and MRD-negative very good partial response (VGPR)+, Sustained MRD negativity, Duration of response, Time to progression, Time to next treatment, Incidence, seriousness, and severity of all adverse events (AEs), Levels of anti-anitocabtagene autoleucel chimeric antigen receptor (CAR) antibodies (anitocabtagene autoleucel arm), Presence of replication-competent lentivirus (RCL) (anitocabtagene autoleucel arm), Change from baseline quality of life scores across postbaseline assessment visits as measured by: European Organisation for Research and Treatment of Cancer Quality of Life Questionnaire (EORTC QLQ-C30). European Organisation for Research and Treatment of Cancer Quality of Life Questionnaire – Multiple Myeloma Module (EORTC QLQ-MY20). European Quality of Life 5-Dimension 5-Level Scale (EQ-5D-5L), Frequency of hospitalizations, inpatient days, intensive care unit days, and reasons for hospitalization

Source: https://euclinicaltrials.eu/ctis-public/view/2024-511188-26-00